EU clinical trial 2024-519890-21-00: PROSPECTIVE RANDOMISED CLINICAL TRIAL TO EVALUATE THE EARLY RECURRENCE RATE IN NON-MUSCLE INVASIVE BLADDER CANCER BETWEEN THE USE OF CHEMOHYPERTHERMIA (QH) WITH MITOMYCIN-C PRIOR TO TRANSURETHRAL BLADDER RESECTION IN A MAJOR OUTPATIENT SURGERY PROGRAMME AND TREATMENT WITH MITOMYCIN-C IN NORMOTHERMIA POST-RESECTION.
Protocol code: PREMITO2015
Sponsor: University Hospital Of Canary Islands (Hospital/Clinic/Other health care facility). Phase: Phase III and phase IV (Integrated). Countries: Spain (authorised, recruitment pending).
Therapeutic area(s): Diseases [C] - Neoplasms [C04]
Gender: Female, Male. Age: 18-64 years, 65+ years. Enrolment: 152.
Status: Authorised, recruitment pending. Decision date: 2024-11-28. Results received: No. Last updated: 2024-11-28.

Condition(s): Non-muscle invasive bladder cancer

Source: https://euclinicaltrials.eu/ctis-public/view/2024-519890-21-00